EU clinical trial 2024-514015-96-00: A first-in-human study to investigate safety and tolerability of SAR446959 in participants with osteoarthritis of the knee
Protocol code: SAD18258
Sponsor: Sanofi-Aventis Recherche & Developpement (Pharmaceutical company). Phase: Human Pharmacology (Phase I)- First administration to humans. Countries: Germany (ended).
Therapeutic area(s): Diseases [C] - Musculoskeletal Diseases [C05]
Gender: Female, Male. Age: 18-64 years. Enrolment: 230.
Status: Ended. Start date (EU): 2024-11-20. End date (EU): 2025-12-18. Decision date: 2024-11-12. Results received: No. Last updated: 2025-07-08.

Condition(s): Osteoarthritis

Source: https://euclinicaltrials.eu/ctis-public/view/2024-514015-96-00